EU clinical trial 2024-518508-31-00: EdoxabaN foR IntraCranial Hemorrhage survivors with Atrial Fibrillation
Protocol code: ENRICH-AF
Sponsor: Hamilton Health Sciences Corporation, PHRI Population Health Research Institute International (Hospital/Clinic/Other health care facility, Laboratory/Research/Testing facility). Phase: Therapeutic use (Phase IV). Countries: Spain (authorised, recruitment pending), Austria (authorised, recruitment pending), Czechia (authorised, recruitment pending), Greece (authorised, recruitment pending), Belgium (authorised, recruitment pending), Italy (authorised, recruitment pending), Germany (authorised, recruitment pending), Denmark (authorised, recruitment pending), Slovakia (authorised, recruitment pending), Portugal (authorised, recruitment pending).
Therapeutic area(s): Diseases [C] - Cardiovascular Diseases [C14]
Gender: Female, Male. Age: 18-64 years, 65+ years. Enrolment: 380.
Status: Authorised, recruitment pending. Decision date: 2024-12-09. Results received: No. Last updated: 2026-08-07.
Decision dates by country: CZ: 2024-12-11, DK: 2024-12-10, GR: 2025-01-23, SK: 2024-12-09, PT: 2024-12-10, IT: 2024-12-16, AT: 2024-12-15, BE: 2024-12-11, DE: 2024-12-11, ES: 2024-12-12

Condition(s): High risk atrial fibrillation patients with previous intracranial hemorrhage
Product: Lixiana 60 mg film-coated tablets, Lixiana 30 mg film-coated tablets

Primary endpoint: The primary efficacy end point is composite risk of stroke (ischemic, hemorrhagic and unspecified stroke) or systemic embolism., The primary safety endpoint is major hemorrhage as defined by the International Society on Thrombosis and Haemostasis (ISTH) criteria
Endpoint(s): Ischemic stroke, Cardiovascular death, Hemorrhagic stroke, Disabling/fatal stroke, Systemic embolism, Composite of all stroke, myocardial infarction, systemic embolism or all cause death, Net clinical benefit (composite of stroke, systemic embolism, myocardial infarction, cardiovascular death, fatal bleeding, and symptomatic bleeding into a critical organ or area), Modified Rankin scale (mRS) at 12 months, The secondary safety end point(s) are: All intracranial hemorrhage (intracerebral hemorrhage, intraventricular hemorrhage, subdural hematoma, subarachnoid hemorrhage), Fatal intracranial hemorrhage, Subdural hemorrhage, Hospitalization for any cause

Source: https://euclinicaltrials.eu/ctis-public/view/2024-518508-31-00